EU clinical trial 2023-508464-30-00: BevacizuMAV : Evaluation of the efficacy and safety of anti-angiogenic treatment with intravenous bevacizumab in patients with symptomatic cerebral arteriovenous malformations
Protocol code: BevacizuMAV
Sponsor: Hopital Fondation Adolphe De Rothschild (Hospital/Clinic/Other health care facility). Phase: Therapeutic exploratory (Phase II). Countries: France (ongoing, recruiting).
Therapeutic area(s): Diseases [C] - Nervous System Diseases [C10]
Gender: Female, Male. Age: 18-64 years, 65+ years. Enrolment: 54.
Status: Ongoing, recruiting. Start date (EU): 2024-10-24. Decision date: 2024-02-06. Results received: No. Last updated: 2026-07-08.

Condition(s): cerebral arteriovenous malformations
Product: Abevmy 25 mg/mL concentrate for solution for infusion., 100 mL of NaCl 0.9%.

Primary endpoint: Comparison between the two arms of the proportion of patients showing at least one of the following improvements at 6 months: Increase of at least 5 points in MoCA score / Reduction of at least 4 points in NIHSS score / Improvement of at least one stage in epilepsy balance score - Reduction of at least 12 points on HIT-6 headache score
Endpoint(s): Increase of at least 5 points in MoCA score between M0 and M6, Reduction of at least 4 points in NIHSS score between M0 and M6, Reduction of at least one stage in epilepsy balance score between M0 and M6, Reduction of at least 12 points in HIT-6 score between M0 and M6, Cerebral hemorrhage diagnosed by cerebral MRI at 6 months, Percentage reduction in diameter of AVM drainage veins between brain MRI at M0 and M6, Evolution of peri-MAV edema on brain MRI between M0 and M6 according to the following categorization: improvement, stable or worsening, Modified Rankin score (mRS) <2 at M6, Change in modified Rankin score (mRS) between M0 and M6, Change in EQ-5D-5L score from M0 to M6, All-cause mortality at 6 months, Evolution of plasma VEGF concentration between M0 and M6, MoCA, HIT-6, NIHSS and epilepsy balance scores at 12 months, mRS score at 12 months, EQ-5D-5L score at 12 months, Rate of occurrence of cerebral haemorrhage diagnosed by cerebral MRI at 12 months, Rate of occurrence of adverse events at 12 months

Source: https://euclinicaltrials.eu/ctis-public/view/2023-508464-30-00